EU clinical trial 2024-512510-17-00: A randomized, single-center, double-blind, placebo-controlled, first-in-human trial with single and multiple ascending doses to determine safety, tolerability, and pharmacokinetics of GRT7040 in healthy volunteers
Protocol code: HP7040-01
Sponsor: Gruenenthal GmbH (Pharmaceutical company). Phase: Human Pharmacology (Phase I)- First administration to humans. Countries: Germany (ended).
Therapeutic area(s): Diseases [C] - Pathological Conditions, Signs and Symptoms [C23]
Gender: Female, Male. Age: 18-64 years. Enrolment: 112.
Status: Ended. Start date (EU): 2024-08-05. End date (EU): 2026-02-25. Decision date: 2024-07-10. Results received: No. Last updated: 2025-10-20.
Decision dates by country: DE: 2024-09-27

Condition(s): Treatment of pain

Source: https://euclinicaltrials.eu/ctis-public/view/2024-512510-17-00